EU clinical trial 2022-502103-30-00: IFCT-2201 ADAPTABLE A non-comparative randomized phase II trial evaluating the combination of paclitaxel-bevacizumab ± atezolizumab in patients with advanced non-squamous NSCLC progressing after immunotherapy and chemotherapy
Protocol code: IFCT-2201
Sponsor: Intergroupe Francophone de Cancerologie Thoracique (Pharmaceutical company). Phase: Therapeutic exploratory (Phase II). Countries: France (ongoing, recruitment ended).
Therapeutic area(s): Diseases [C] - Neoplasms [C04]
Gender: Female, Male. Age: 18-64 years, 65+ years. Enrolment: 156.
Status: Ongoing, recruitment ended. Start date (EU): 2023-04-25. Decision date: 2023-02-16. Results received: No. Last updated: 2024-04-08.

Condition(s): advanced non-squamous non-small cell lung cancer
Product: BEVACIZUMAB, PACLITAXEL, Tecentriq 1,200 mg concentrate for solution for infusion

Primary endpoint: Progression free survival (PFS) at 6 months as determined by independent reviewer.
Endpoint(s): PFS at 6 months as determined by investigator assessment, Objective response rate (ORR), Overall survival, PFS, Incidence, nature, and severity of adverse events, graded according to the National Cancer Institute Common Terminology Criteria for Adverse Events, Version 5.0 (NCI CTCAE v5.0), Clinically significant changes in symptoms, function, and HRQoL scales from the patient-completed European Organization for Research and Treatment of Cancer Quality of Life Questionnaire-Core 30 (EORTC QLQ-C30 LC13); overall health status will also be assessed using the EQ-5D-5L including visual analogue scale (VAS).

Source: https://euclinicaltrials.eu/ctis-public/view/2022-502103-30-00